EU clinical trial 2024-517531-40-00: Dosimetry, kinetics and test-retest properties of a novel norepinephrine transporter radiotracer [18F]NS12137
Sponsor: Varsinais-Suomen hyvinvointialue (Hospital/Clinic/Other health care facility). Phase: Human Pharmacology (Phase I)- First administration to humans. Countries: Finland (authorised, recruitment pending).
Therapeutic area(s): Not possible to specify
Gender: Male. Age: 18-64 years. Enrolment: 15.
Status: Authorised, recruitment pending. Decision date: 2025-02-04. Results received: No. Last updated: 2025-03-07.
Decision dates by country: FI: 2025-03-07

Condition(s): Phase I trial, healthy volunteers

Source: https://euclinicaltrials.eu/ctis-public/view/2024-517531-40-00